EU clinical trial 2023-504881-42-01: A randomized, investigator masked pilot study to establish the experimental conditions and select the criteria to compare topical application of 2 methyl aminolevulinate creams: evaluation of protoporphyrin IX formation in the skin of healthy subjects.
Protocol code: TOP009
Sponsor: Substipharm (Pharmaceutical company). Phase: Human Pharmacology (Phase I)- Other. Countries: France (ended).
Therapeutic area(s): Not possible to specify
Gender: Female, Male. Age: 18-64 years. Enrolment: 12.
Status: Ended. Start date (EU): 2024-09-25. End date (EU): 2024-10-18. Decision date: 2024-07-25. Results received: No. Last updated: 2024-07-25.

Condition(s): None - Healthy subjects

Source: https://euclinicaltrials.eu/ctis-public/view/2023-504881-42-01